EU clinical trial 2023-503174-20-00: Sotorasib in advanced KRAS G12C-mutated non-small cell lung cancer patients with comorbidities (SOLUCOM)
Protocol code: 20207314
Sponsor: Vestre Viken HF (Hospital/Clinic/Other health care facility). Phase: Therapeutic exploratory (Phase II). Countries: Norway (ongoing, recruitment ended), Denmark (ongoing, recruitment ended), Sweden (ongoing, recruitment ended).
Therapeutic area(s): Diseases [C] - Neoplasms [C04]; Diseases [C] - Respiratory Tract Diseases [C08]
Gender: Female, Male. Age: 18-64 years, 65+ years. Enrolment: 96.
Status: Ongoing, recruitment ended. Start date (EU): 2022-05-30. Decision date: 2024-02-16. Results received: No. Last updated: 2026-05-27.
Decision dates by country: SE: 2024-09-05, DK: 2024-09-10, NO: 2024-02-16

Condition(s): KRAS G12C-mutated non-small cell lung cancer
Product: SOTORASIB

Primary endpoint: Objective Response Rate (ORR) of sotorasib in the all subjects treated population
Endpoint(s): Objective Response Rate (ORR) of sotorasib in the predefined patient groups (including ECOG PS2, specific comorbidities, including immune-related adverse events after (chemo-) immunotherapy), Progression Free Survival (PFS), Duration of Response (DoR), Disease Control Rate (DCR), Intracranial Disease Free Survival (iDFS), Intracranial Time To Recurrence (iTTR), Tumour shrinkage, Overall Survival (OS), Time on treatment post progression, Change from baseline over time to week 12 in disease related symptoms, physical functioning and global health status as measured by QLQ-C30 and QLQ-LC13, To estimate the subject incidence of treatment-emergent adverse events, treatment-related adverse events, changes in vital signs, and clinical laboratory tests, Molecular characterization (see below) of blood and tissue before commencement on sotorasib, at response and at progression on sotorasib, NGS (deep targeted sequencing of tumour tissue), STK11/LKB1, KEAP1, p53 etc, Molecular analyses (incl NGS, e.g. Avenio) of blood samples (ctDNA), Array-based microRNA, methylation, mRNA expression, Protein analyses based on IHC, including immune-markers as PD-L1, IL-10, STING, TGFbeta etc, Exploratory analyses to be determined, Intracranial Objective Response Rate (iORR), Intracranial Disease Control Rate (iDCR), Intracranial Duration of response (iDoR), Intracranial Progression Free Survival (iPFS)

Source: https://euclinicaltrials.eu/ctis-public/view/2023-503174-20-00